EU clinical trial 2024-519871-24-00: IZABRIGHT-Breast01: A Randomized, Open-label, Inferentially Seamless Phase 2/3 Study of Izalontamab Brengitecan (BMS-986507) versus Treatment of Physician’s Choice in Patients with Previously Untreated, Locally Advanced, Recurrent Inoperable, or Metastatic Triple-negative Breast Cancer (TNBC) or ER-low, HER2-negative BC who are Ineligible for Anti-PD1/PD-L1 Treatment
Protocol code: CA244-0008
Sponsor: Bristol-Myers Squibb Services Unlimited Company (Pharmaceutical company). Phase: Phase II and Phase III (Integrated). Countries: France (ongoing, recruiting), Portugal (ongoing, recruiting), Romania (ongoing, recruiting), Greece (ongoing, recruiting), Italy (ongoing, recruiting), Spain (ongoing, recruiting), Sweden (ongoing, recruiting), Austria (ongoing, recruiting), Poland (ongoing, recruiting), Germany (ongoing, recruiting).
Therapeutic area(s): Diseases [C] - Neoplasms [C04]
Gender: Female, Male. Age: 18-64 years, 65+ years. Enrolment: 159.
Status: Ongoing, recruiting. Start date (EU): 2025-11-11. Decision date: 2025-10-17. Results received: No. Last updated: 2026-07-06.
Decision dates by country: DE: 2025-10-22, SE: 2025-10-20, ES: 2025-10-20, AT: 2025-10-20, GR: 2025-10-20, PL: 2025-10-26, PT: 2025-10-20, RO: 2025-10-22, IT: 2025-10-22, FR: 2025-10-17

Condition(s): Breast cancer, Triple-negative breast cancer
Product: PEGFILGRASTIM, BL-B01D1, CARBOPLATIN, PACLITAXEL, PACLITAXEL ALBUMIN-BOUND, CAPECITABINE, CAPECITABINE, GEMCITABINE

Primary endpoint: PFS (progression-free survival) by BICR (Blinded Independent Central Review) The ability of iza-bren to work better than other common treatments chosen by the doctors is tested by looking at the PFS, which shows how long it takes for the disease to get worse by radiographic imaging techniques (like CT scans).
Endpoint(s): This study will assess if people live longer when they take iza-bren compared to other treatments chosen by the doctors. This is what is called "Overall Survival"

Source: https://euclinicaltrials.eu/ctis-public/view/2024-519871-24-00